EU clinical trial 2025-521390-14-00: Revumenib Treatment in Combination with FLA Chemotherapy in Paediatric Refractory/Relapsed KMT2A-r, NUP98-r or NPM1-mut Acute Myeloid Leukemia (AML)
Protocol code: STRIVE
Sponsor: Pediatric Research International GmbH (Patient organisation/association). Phase: Therapeutic exploratory (Phase II). Countries: Denmark (authorised, recruiting), Italy (authorised, recruitment pending), Czechia (authorised, recruitment pending), Sweden (authorised, recruitment pending), Poland (authorised, recruitment pending), Netherlands (authorised, recruitment pending), Germany (authorised, recruitment pending), Austria (authorised, recruitment pending).
Therapeutic area(s): Diseases [C] - Neoplasms [C04]
Gender: Female, Male. Age: 0-17 years, 18-64 years. Enrolment: 31.
Start date (EU): 2026-06-22. Decision date: 2026-02-16. Results received: No. Last updated: 2026-08-04.
Decision dates by country: DK: 2026-02-16, IT: 2026-02-20, PL: 2026-02-22, AT: 2026-02-20, SE: 2026-02-20, CZ: 2026-02-19, NL: 2026-02-19, DE: 2026-02-19

Condition(s): Acute Myeloid Leukemia
Product: Revumenib, CYTARABINE, Revumenib, Revumenib, FLUDARABINE, Revumenib

Primary endpoint: The primary efficacy endpoint of Part I in this study is to estimate the ORR. We will compare the ORR to a historically informed null ORR rate of 37% after up to 2 cycles with revumenib in combination with FLA in R/R KMT2A-r, NUP98-r or NPM1- mut AML.

Source: https://euclinicaltrials.eu/ctis-public/view/2025-521390-14-00